EU clinical trial 2024-518259-49-00: Phase III randomized, multicenter open label clinical trial to evaluate the efficacy of immunomodulatory therapy in case of psychiatric disorders with proven dysimmunity. TIM-DePisT
Protocol code: CHUBX 2019/59
Sponsor: Centre Hospitalier Universitaire De Bordeaux (Hospital/Clinic/Other health care facility). Phase: Therapeutic confirmatory (Phase III). Countries: France (ongoing, recruiting).
Therapeutic area(s): Psychiatry and Psychology [F] - Mental Disorders [F03]
Gender: Female, Male. Age: 0-17 years, 18-64 years, 65+ years. Enrolment: 1000.
Status: Ongoing, recruiting. Start date (EU): 2024-07-04. Decision date: 2024-10-24. Results received: No. Last updated: 2025-10-03.

Condition(s): Mental Disorder
Product: Ruxience 500 mg concentrate for solution for infusion, MabThera 500 mg concentrate for solution for infusion

Primary endpoint: The primary endpoint outcome is the remission of psychiatric symptoms at 3 months, defined as: For adult and adolescent patients (who reached 17 years old at step 1 inclusion visit) : 20% decrease from baseline of BPRS-E scale. For children patients aged between 6 and 16 years old at step 1 inclusion visit: 25% decrease from baseline of ABC (Aberrant Behavior Checklist) scale.
Endpoint(s): for adults and adolescents : general functioning measurement with the GAF scale, for adults and adolescents : cognitive assessment thanks to the MOCA scale, for adults and adolescents : neurologic evaluation with the 2 scales KREBS and BUSH, for adults and adolescents : psychotic disorders measurement with the PANSS scale, for adults and adolescents : assessment of the evolution of depressive and manic disorders thanks to the MADRS and YMRS scales., for children (aged between 6 and 16 years old at step 1 inclusion visit) :psychotic disorders measurement with the PANSS scale, for children : assessment of the evolution of depressive and manic disorders thanks to the CDRS and YMRS scales, for children : neurologic evaluation BUSH scale, for all: Persistence rate of autoimmunity in psychiatric disorder at baseline for all participants to the Step 1 of the trial, for all: Remission of psychiatric symptoms in each group of participants to the Step 2 of the trial, at M1, M6 and M12, for all: Evaluation of severity and improvement with CGI-S and CGI-I, for all: Level of autoimmune Abs at 3 months in each group of participants to the Step 2 of the trial, for all: Frequency and nature of serious and non-serious adverse events as well as infections in each arm.

Source: https://euclinicaltrials.eu/ctis-public/view/2024-518259-49-00